EU clinical trial 2023-503749-76-00: A Study to Evaluate Safety and Anti-Tumor Activity of RO7284755 Alone or in Combination with Atezolizumab in Participants with Advanced and/or Metastatic Solid Tumors
Protocol code: BP41628
Sponsor: F. Hoffmann-La Roche AG (Pharmaceutical company). Phase: Human Pharmacology (Phase I)- First administration to humans. Countries: Denmark (ended), Spain (ended), Poland (ended), Netherlands (ended), Belgium (ended).
Therapeutic area(s): Diseases [C] - Neoplasms [C04]
Gender: Female, Male. Age: 18-64 years, 65+ years. Enrolment: 162.
Status: Ended. Start date (EU): 2020-03-06. End date (EU): 2025-10-02. End date: 2025-10-03. Decision date: 2023-12-19. Results received: No. Last updated: 2025-01-21.
Decision dates by country: DK: 2023-12-19, BE: 2023-12-21, PL: 2024-01-10, ES: 2023-12-19, NL: 2023-12-22

Condition(s): Solid Tumors

Source: https://euclinicaltrials.eu/ctis-public/view/2023-503749-76-00